EU clinical trial 2024-518774-14-00: SGL-TX-PTDM: SGLT2i effect on PTDM development and kidney allograft function in kidney transplant recipients: A randomized, double-blind, placebo controlled, national multicenter trial
Sponsor: Odense University Hospital (Hospital/Clinic/Other health care facility). Phase: Therapeutic exploratory (Phase II). Countries: Denmark (authorised, recruitment pending).
Therapeutic area(s): Not possible to specify
Gender: Female, Male. Age: 18-64 years, 65+ years. Enrolment: 184.
Status: Authorised, recruitment pending. Decision date: 2026-03-09. Results received: No. Last updated: 2026-03-09.

Condition(s): Kidney transplant recipients
Product: Forxiga 10 mg film-coated tablets, The placebo medicinal product is manufactured by the Capital Region Hospital Pharmacy (Region Hovedstadens Apotek). The placebo tablet is white, round, and biconvex, with a diameter of 8 mm. It consists of lactose monohydrate, potato starch, gelatin A, purified water, magnesium stearate (MF2V), and talc. The tablets are over-encapsulated in an opaque hard gelatin capsule identical in appearance to the capsule containing the active Forxiga® tablet. For further details, please refer to document G1_sIMPD_Q Placebo.

Primary endpoint: • Post Transpalnt Diabetes Mellitus incidence after 6 and 12 months follow-up
Endpoint(s): Prediabetes incidence after 6 and 12 month follow-up, eGFR change after 6 and 12 month follow up., Proteinuria determined by Albumin/creatinine ratio (U-ACR) (mg/g), Change in creatinine and Cholesterol after 6 and 12 month follow-up, Incidence og urinaty tract infection determined by (positive urine culture), Incidence of kidney transplant rejection (biopsy verified), Renal composite outcome o Incidence of graft failure (defined as return to dialysis or retransplantation) o Incidence of ESRD (defined as eGFR<15 ml/min/1.73m2) o Incidence of > 25% increase in creatinine, Change in Systolic blood pressure (SysBP) (mmHg) and diastolic blood pressure (DiaBP) (mmHg), Relative incidence of out-of-target measures of clinical routine blood Tacrolimus levels, Urine biomarkers indicative of podocyt and tubular function from selected sites, Incidence of Adverse events, Incidence of Serious adverse events, Incidence of serious adverse reactions, Incidence of death (all cause mortality), Incidence of Major Adverse Cardiac Events (MACE), Change in score for Short Form Health Survey 36 between baseline and after 12 month follow-up

Source: https://euclinicaltrials.eu/ctis-public/view/2024-518774-14-00